EU clinical trial 2022-502288-40-00: A Phase 1/Phase 2 Study to Evaluate the Safety and Tolerability of MK-1088 as Monotherapy and in Combination with Pembrolizumab in Participants with Advanced Solid Tumors
Protocol code: MK-1088-002
Sponsor: Merck Sharp & Dohme LLC (Pharmaceutical company). Phase: Therapeutic exploratory (Phase II). Countries: Denmark (ended).
Therapeutic area(s): Diseases [C] - Neoplasms [C04]
Gender: Female, Male. Age: 18-64 years, 65+ years. Enrolment: 16.
Status: Ended. Start date (EU): 2022-06-29. End date (EU): 2023-08-30. End date: 2023-09-07. Decision date: 2023-02-28. Results received: Yes. Last updated: 2023-08-01.

Condition(s): Treatment of advanced/metastatic solid tumors
Product: KEYTRUDA 25 mg/mL concentrate for solution for infusion

Primary endpoint: Number of Participants Experiencing Dose-Limiting Toxicities (DLTs), Number of Participants Experiencing Adverse Events (AEs, Number of Participants Discontinuing Study Treatment Due to AEs
Endpoint(s): Area Under the Plasma Concentration-Time Curve (AUC) of MK-1088, Maximum Plasma Concentration (Cmax) of MK-1088, Minimum Plasma Concentration (Cmin) of MK-1088, Objective Response Rate (ORR)

Source: https://euclinicaltrials.eu/ctis-public/view/2022-502288-40-00